EU clinical trial 2024-512442-41-00: A Phase 1/2 Study to Evaluate the Safety and Efficacy of Patritumab Deruxtecan in Gastrointestinal Cancers
Protocol code: MK-1022-011
Sponsor: Merck Sharp & Dohme LLC (Pharmaceutical company). Phase: Phase I and Phase II (Integrated)- Other. Countries: Spain (ongoing, recruiting), France (ongoing, recruiting), Italy (ongoing, recruiting).
Therapeutic area(s): Diseases [C] - Neoplasms [C04]
Gender: Female, Male. Age: 18-64 years, 65+ years. Enrolment: 48.
Status: Ongoing, recruiting. Start date (EU): 2024-12-03. Decision date: 2024-11-06. Results received: No. Last updated: 2026-04-17.
Decision dates by country: FR: 2024-11-08, IT: 2025-01-21, ES: 2024-11-06

Condition(s): Colorectal Carcinoma, Biliary Tract Carcinoma, Hepatocellular Carcinoma
Product: MK-1022

Primary endpoint: Number of Participants Experiencing Dose-Limiting Toxicity (DLT) (Dose-Escalation Phase), Number of Participants with One or More Adverse Events (AEs), Number of Participants who Discontinue Study Intervention Due to an AE, Objective Response Rate (ORR)
Endpoint(s): Duration of Response (DOR), Progression Free Survival (PFS), Overall Survival (OS), Maximum Plasma Concentration (Cmax) of Patritumab Deruxtecan, Trough Concentration (Ctrough) of Patritumab Deruxtecan

Source: https://euclinicaltrials.eu/ctis-public/view/2024-512442-41-00